EU clinical trial 2024-513801-30-00: PRESENT - Prophylaxis of Recurrent Erysipelas in lower limbs: compreSsion thErapy vs aNTibiotics and compression therapy. A non-inferiority, randomized, multicenter clinical trial.
Protocol code: DR230313
Sponsor: Centre Hospitalier Regional Universitaire De Tours (Hospital/Clinic/Other health care facility). Phase: Therapeutic confirmatory (Phase III). Countries: France (authorised, recruitment pending).
Therapeutic area(s): Diseases [C] - Bacterial Infections and Mycoses [C01]; Diseases [C] - Skin and Connective Tissue Diseases [C17]
Gender: Female, Male. Age: 18-64 years, 65+ years. Enrolment: 200.
Status: Authorised, recruitment pending. Decision date: 2025-07-07. Results received: No. Last updated: 2025-07-07.

Condition(s): Recurrent Erysipelas in lower limbs
Product: PHENOXYMETHYLPENICILLIN, PHENOXYMETHYLPENICILLIN

Primary endpoint: Proportion of patients with at least one recurrence of erysipelas during the 1-year prophylaxis phase, performed by a assessor-blinded.
Endpoint(s): Time to the first confirmed recurrence of erysipelas., Severity of recurrence: number of nights in hospital for cellulitis., Presence of skin necrosis or ulceration., Assessment of adverse effects and serious adverse effects during the prophylaxis phase., Quality of life: Dermatology Life Quality Index and EQ-5D-5L, Adherence: number of days per week that compression was worn (using a patient book)., Assessment of oedema by circumferential measurements and using the truncated cone formula., Number of days per week that antibiotics is taken (using a patient book), Health-economic: Probability that the experimental strategy is clinically and economically non-inferior to the control strategy for different values of economic non-inferiority margin and for a constant clinical non-inferiority margin (15%).

Source: https://euclinicaltrials.eu/ctis-public/view/2024-513801-30-00